EU clinical trial 2025-522361-30-00: A Phase III, randomised, double-blind, placebo-controlled, parallel-group, pivotal trial to assess the efficacy and safety of sonlicromanol in adult subjects with a genetically confirmed mitochondrial DNA tRNALeu(UUR) m.3243A>G variant.
Protocol code: KH176-301
Sponsor: Khondrion B.V. (Pharmaceutical company). Phase: Therapeutic confirmatory (Phase III). Countries: Italy (ongoing, recruiting), Germany (authorised, recruitment pending), France (authorised, recruitment pending), Netherlands (ongoing, recruiting), Denmark (authorised, recruitment pending).
Therapeutic area(s): Diseases [C] - Nervous System Diseases [C10]
Gender: Female, Male. Age: 18-64 years. Enrolment: 160.
Start date (EU): 2026-03-17. Decision date: 2025-12-19. Results received: No. Last updated: 2026-05-19.
Decision dates by country: FR: 2025-12-19, DK: 2025-12-19, NL: 2025-12-19, IT: 2026-01-08, DE: 2025-12-22

Condition(s): Primary Mitochondrial Disease, Mitochondrial DNA 3243A>G variant and Associated Phenotypes (MIDD, MELAS, Multi System Phenotypes
Product: sonlicromanol.HCl, Matching placebo (containing microcrystalline cellulose (MCC))

Primary endpoint: Change from baseline at Week 52 in the: 1. NeuroQoL Fatigue SF v1 score, Change from baseline at Week 52 in the: 2. Duration of the 5 Times Sit-to-Stand Test (5xSST)
Endpoint(s): Change from baseline at Week 52 in the: 1. 36-Item Short Form Survey (SF-36): sub-score physical functioning, Change from baseline at Week 52 in the: 2. Fatigue Severity Scale (FSS), Change from baseline at Week 52 in the: 3. Beck Depression Inventory (BDI-2) total score, Change from baseline at Week 52 in the: 4. Patient reported global impression of severity (PGI-S), Change from baseline at Week 52 in the: 5. Clinician reported global impression of severity (CGI-S)

Source: https://euclinicaltrials.eu/ctis-public/view/2025-522361-30-00